EU clinical trial 2023-508369-34-00: Phase I study of IAG933 in patients with advanced Mesothelioma and other solid tumors
Protocol code: CIAG933A12101
Sponsor: Novartis Pharma AG (Pharmaceutical company). Phase: Human Pharmacology (Phase I)- First administration to humans. Countries: Italy (ongoing, recruitment ended), Germany (ongoing, recruitment ended), France (ongoing, recruitment ended), Spain (ongoing, recruitment ended), Netherlands (ongoing, recruitment ended).
Therapeutic area(s): Diseases [C] - Neoplasms [C04]
Gender: Female, Male. Age: 18-64 years, 65+ years. Enrolment: 89.
Status: Ongoing, recruitment ended. Start date (EU): 2021-12-07. Decision date: 2024-02-20. Results received: No. Last updated: 2026-05-11.
Decision dates by country: NL: 2024-02-20, FR: 2024-02-26, ES: 2024-03-18, IT: 2024-03-15, DE: 2024-02-23

Condition(s): Advanced mesothelioma or other solid tumors harboring certain molecular alterations in the Hippo pathway

Source: https://euclinicaltrials.eu/ctis-public/view/2023-508369-34-00